EU clinical trial 2022-502196-31-00: A Phase 2/3 Study of Navtemadlin as Maintenance Therapy in Subjects with TP53WT Advanced or Recurrent Endometrial Cancer Who Responded to Chemotherapy
Protocol code: KRT-232-118
Sponsor: Kartos Therapeutics Inc. (Pharmaceutical company). Phase: Phase II and Phase III (Integrated). Countries: Lithuania (ended), Estonia (ended), Denmark (ended), Norway (ended), Hungary (ended), Spain (ended), Poland (ended), Slovenia (ended), Romania (ended), Italy (ended), Sweden (ended), Austria (ended), Czechia (ended), Finland (ended), France (ended).
Therapeutic area(s): Diseases [C] - Neoplasms [C04]
Gender: Female. Age: 18-64 years, 65+ years. Enrolment: 140.
Status: Ended. Start date (EU): 2023-08-21. End date (EU): 2024-07-26. End date: 2024-08-29. Decision date: 2023-07-21. Results received: Yes. Last updated: 2024-05-15.
Decision dates by country: RO: 2023-07-25, DK: 2023-07-21, CZ: 2023-09-21, HU: 2023-07-21, FI: 2023-10-25, ES: 2023-07-25, FR: 2024-04-19, SI: 2023-07-25, NO: 2023-07-25, EE: 2023-07-25, AT: 2023-07-25, SE: 2023-07-26, LT: 2023-07-25, IT: 2023-07-21, PL: 2023-07-25

Condition(s): Advanced or Recurrent Endometrial Cancer
Product: LOPERAMIDE, Placebo to match ondansetron, capsule, Navtemadlin 25-30, ONDANSETRON, Placebo to match navtemadlin, film coated tablet, ONDANSETRON, Placebo to match loperamide, capsule, LOPERAMIDE HYDROCHLORIDE, Navtemadlin 25-60

Primary endpoint: Part 1: Safety review committee (SRC) will determine the navtemadlin Phase 3 dose for Part 2 based on safety data from Part 1. Part 2: PFS defined as the time from randomization to disease progression by IRC or death, whichever occurs first
Endpoint(s): Part 1: PFS defined as the time from randomization to disease progression by IRC/investigator assessment or death, whichever occurs first, Part 2: - PFS defined as the time from randomization to disease progression by investigator assessment or death, whichever occurs first. - TFST defined as the time from randomization to initiation of first subsequent anti-cancer therapy or death, whichever occurs first., Part 1&2: OS defined as the time from randomization to death of any cause, Part 1&2: IRC/investigator assessed response per RECIST 1.1 (Appendix 4 of the protocol), Part 1&2: Best response of complete response (CR), partial response (PR) or stable disease (SD) by IRC/investigator assessment among subjects with PR as best response from prior chemotherapy, Part 1&2: Navtemadlin and acyl glucuronide metabolite (M1) PK parameters, including but not limited to: • Maximum observed concentration (Cmax) • Time to maximum plasma concentration (Tmax) • Area under the plasma concentration-time curve (AUC), Part 1&2: • Incidence, nature and severity of adverse events (AEs) and serious adverse events (SAEs) • Changes in laboratory values, electrocardiograms (ECGs) and vital signs

Source: https://euclinicaltrials.eu/ctis-public/view/2022-502196-31-00